EU clinical trial 2023-505446-25-00: A Phase 1b/2a, Dose Escalation Study of Safety, Pharmacokinetic/Pharmacodynamic and Preliminary Clinical Activity of Briquilimab in Adult Patients With Chronic Spontaneous Urticaria (CSU) Who Remain Sympomatic Despite Treatment with H1 Antihistamines and/or Omalizumab, or who Cannot Tolerate Omalizumab
Protocol code: JSP-CP-011
Sponsor: Jasper Therapeutics Inc. (Pharmaceutical company). Phase: Phase I and Phase II (Integrated)- Other. Countries: Germany (ended).
Therapeutic area(s): Diseases [C] - Skin and Connective Tissue Diseases [C17]; Diseases [C] - Immune System Diseases [C20]
Gender: Female, Male. Age: 18-64 years, 65+ years. Enrolment: 31.
Status: Ended. Start date (EU): 2024-03-20. End date (EU): 2026-07-08. End date: 2026-07-09. Decision date: 2023-12-19. Results received: No. Last updated: 2026-07-02.

Condition(s): Chronic Spontaneous Urticaria
Product: Briquilimab, Placebo (10 mM sodium acetate, 9.0% (w/v) sucrose, 0.02% (w/v) polysorbate 20, pH 5.2), EPINEPHRINE

Primary endpoint: Incidence and severity of treatment emergent AEs/SAEs, Laboratory assessments ECG, vital signs
Endpoint(s): Urticaria Activity Score over 7 days (UAS7); Hive Severity Score over 7 days (HSS7); Itch Severity Score over 7 days (ISS7); Urticaria Control Test (UCT), Complete response rate: Proportion of participants who are urticaria free based on UAS7 = 0., Well-controlled rate: Proportion of participants who are well controlled based on UAS7 ≤ 6 or UCT ≥ 12, Time to complete response or well-controlled disease, Time to relapse, Serum PK concentration of briquilimab over time. Modeled serum PK parameters of briquilimab including but not limited to Cmax, Cmin and AUC as appropriate

Source: https://euclinicaltrials.eu/ctis-public/view/2023-505446-25-00